EU clinical trial 2022-502741-10-00: A Phase 1/2, Open-Label, Dose-Escalation, Dose-Expansion Study of Enzomenib (DSP 5336) in Patients with Acute Leukemia and Other Selected Hematologic Malignancies, with and without Mixed Lineage Leukemia (MLL) rearrangement or Nucleophosmin 1 (NPM1) Mutation
Protocol code: DSP-5336-101
Sponsor: Sumitomo Pharma America Inc. (Pharmaceutical company). Phase: Phase I and Phase II (Integrated)- First administration to humans. Countries: Spain (ongoing, recruiting), Belgium (ongoing, recruiting), France (ongoing, recruiting), Italy (ongoing, recruiting).
Therapeutic area(s): Diseases [C] - Neoplasms [C04]
Gender: Female, Male. Age: 0-17 years, 18-64 years, 65+ years. Enrolment: 94.
Status: Ongoing, recruiting. Start date (EU): 2024-01-26. Decision date: 2023-09-01. Results received: No. Last updated: 2026-07-23.
Decision dates by country: ES: 2023-09-01, FR: 2023-09-05, IT: 2023-09-12, BE: 2023-09-04

Condition(s): Acute Leukemia with Mixed Lineage Leukemia (MLL)-rearrangement or Nucleophosmin 1 (NPM1) Mutation
Product: Enzomenib, Enzomenib

Primary endpoint: Phase 1: Safety: Dose-limiting toxicities (DLTs) as assessed by (NCI CTCAE), version 5.0 Phase 2: CR + CRh, Phase 1: Safety: Treatment-emergent adverse events (TEAEs) and serious adverse events (SAEs), Phase 1: Safety: Changes in vital signs, clinical laboratory values (hematology, clinical chemistry, urinalysis), electrocardiogram (ECG) parameters, echocardiogram (ECHO) parameters, Phase 1: Tolerability: Dose interruptions, dose reductions, and/or dose discontinuations, Phase 1: Biologic Efficacy: see corresponding secondary endpoints for PK and clinical activity
Endpoint(s): Phase 1: Plasma DSP-5336 concentration-time profiles, plasma PK parameters of DSP-5336 (ie, AUC, Cmax, tmax, t1/2, and other parameters, as data allow) Phase 2: CR; CRi; PR; MLFS defined by ELN 2017. CRc (CR or CRh or CRi); ORR (= CR or CRi or MLFS); time to CR/CRh; time to ORR; duration of CR/CRh, duration of ORR; TI; OS; EFS, Phase 1: For acute leukemias: Response according to ELN 2017 criteria and criteria for CRh defined by the FDA guidance: CR; CRh; CRi; PR; MLFS; CR+ CRh; ; CRc (CR or CRh or Cri); ORR (=CR or CRi or MLFS); time to CR/CRh;time to ORR; duration of CR/CRh, duration of ORR; TI;OS;EFS Phase2: • TEAEs and SAEs • Changes in vital signs, clinical laboratory values (hematology, clinical chemistry), ECG parameters, Dose modifications, Phase 1: QT interval changes and morphology, assessed in patients receiving DSP-5336 as a single agent or in the presence of azoles QT interval correction will be performed using Fridericia’s formula (QTcF) from triplicate ECGs

Source: https://euclinicaltrials.eu/ctis-public/view/2022-502741-10-00